EU clinical trial 2023-510253-42-00: NUCastle - Nintedanib treatment in Unicentric Castleman disease
Protocol code: APHP220273
Sponsor: Assistance Publique Hopitaux De Paris (Hospital/Clinic/Other health care facility). Phase: Therapeutic exploratory (Phase II). Countries: France (ongoing, recruiting).
Therapeutic area(s): Diseases [C] - Immune System Diseases [C20]
Gender: Female, Male. Age: 18-64 years, 65+ years. Enrolment: 13.
Status: Ongoing, recruiting. Start date (EU): 2026-01-28. Decision date: 2024-07-08. Results received: No. Last updated: 2026-07-24.

Condition(s): Adult patients aged 18 and over with unicentric hyalino-vascular Castleman's disease
Product: Ofev 150 mg soft capsules, Ofev 100 mg soft capsules

Primary endpoint: Best response over 6 months defined as >30% decrease from baseline in Total Lesion Glycolysis (TLG) measured by 18F FDG PET/CT performed at M3 and M6
Endpoint(s): Number of adverse events (AEs), number of serious AEs, nindetanib discontinuation up to Month 9 (M9), Variation from baseline in size, SUV and TLG percentage of the lesion at M3 and M6, Change in the status of non-resectability of the UCD lesion at M6, Evolution of autoimmune-related complications: *Paraneoplastic pemphigus/Bronchiolitis Obliterans: Improvement/Worsening/ Stable disease based on: - pemphigus disease area index (for PNP) at M1, M3, M6 and M9 - bronchiolitis obliterans: change from baseline of the percent of predicted forced expiratory volume in 1 second (FEV1), in forced vital capacity, total lung capacity and DLCO at M3, M6 and M9 - serum antibody titers (anti desmoglein 1/3,anti desmoplakin,anti envoplakin, anti periplakin), Occurrence of paraneoplastic pemphigus and/or myasthenia gravis during follow-up, up to M9, Evaluation of the mutational status of PDGFRB of the lesion (NGS technology) and correlation with treatment response (variation in size, SUV, TLG at M3 and M6), Nintedanib residual plasma concentration at M1, M3, M6

Source: https://euclinicaltrials.eu/ctis-public/view/2023-510253-42-00